EU clinical trial 2024-513042-12-01: Darbepoetin for Ischemic Neonatal Stroke to Augment Regeneration
Protocol code: 16-739
Sponsor: Universitair Medisch Centrum Utrecht (Hospital/Clinic/Other health care facility). Phase: Therapeutic exploratory (Phase II). Countries: Netherlands (ongoing, recruiting).
Therapeutic area(s): Diseases [C] - Nervous System Diseases [C10]
Gender: Female, Male. Age: 0-17 years. Enrolment: 40.
Status: Ongoing, recruiting. Start date (EU): 2024-08-08. Decision date: 2024-08-08. Results received: No. Last updated: 2024-08-08.

Condition(s): Perinatal Arterial Ischemic Stroke (PAIS)
Product: Aranesp 10 micrograms solution for injection in pre-filled syringe, Saline: a solution of sterile normal saline containing 9.0 grams of sodium chloride (NaCl, table salt) per liter (0.90%).

Primary endpoint: Our primary objective is to determine whether there is a difference in the degree in stroke tissue loss between darbepoetin and placebo treatment, which will be measured by the change in lesion size and brain growth between the time of onset of the insult and 6-8 weeks of age. Additionally we will assess whether there are differences between darbepoetin and placebo treatment in DTI parameters of selected regions of interest.
Endpoint(s): We will assess development of USCP, and cognitive development at 18 months of age using the BSID-III and PSOM scores as well as a full neurological assessment including Gross Motor Function Classification system (GMFCS) and several handfunction tests such as Manual Ability Classification System (MACS), the Hand Assessment of Infants (HAI) and Assisting Hand Assessment (AHA) and compare them between groups (darbepoetin vs placebo).

Source: https://euclinicaltrials.eu/ctis-public/view/2024-513042-12-01